EU clinical trial 2023-503575-21-00: Randomized, Controlled, Open-label, Phase 3, Global Multi-Center Trial to Assess the Efficacy and Safety of Zipalertinib plus Chemotherapy versus Chemotherapy alone, in Patients with Previously Untreated, Locally Advanced or Metastatic Nonsquamous Non-Small Cell Lung Cancer (NSCLC) with Epidermal Growth Factor Receptor (EGFR) Exon 20 Insertion (ex20ins) Mutations
Protocol code: TAS6417-301
Sponsor: Taiho Oncology Inc. (Pharmaceutical company). Phase: Therapeutic confirmatory (Phase III). Countries: Netherlands (ongoing, recruitment ended), Germany (ongoing, recruitment ended), Italy (ongoing, recruitment ended), Belgium (ongoing, recruitment ended), France (ongoing, recruitment ended), Spain (ongoing, recruitment ended), Poland (ongoing, recruitment ended), Bulgaria (ended), Greece (ongoing, recruitment ended), Romania (ongoing, recruitment ended).
Therapeutic area(s): Diseases [C] - Neoplasms [C04]
Gender: Female, Male. Age: 18-64 years, 65+ years. Enrolment: 118.
Start date (EU): 2024-01-23. Decision date: 2023-11-27. Results received: No. Last updated: 2026-02-13.
Decision dates by country: FR: 2023-12-04, IT: 2023-11-29, GR: 2024-05-13, BE: 2023-11-28, PL: 2023-11-30, BG: 2024-05-20, DE: 2023-11-29, ES: 2023-11-27, RO: 2024-05-24, NL: 2023-11-28

Condition(s): Non-Small Cell Lung Cancer Harboring EGFR Exon 20 Insertion Mutations
Product: Cisplatin Hikma 1 mg/ml Konzentrat zur Herstellung einer Infusionslösung, Zipalertinib, Carboplatin Hikma 10 mg/ml Konzentrat zur Herstellung einer Infusionslösung, Pemetrexed Fresenius Kabi 100 mg powder for concentrate for solution for infusion

Primary endpoint: PART A: Incidence of dose-limiting toxicities (DLTs) graded according to the NCI-Common Terminology Criteria of Adverse Events (CTCAE) v5.0 during Cycle 1, PART B: PFSS, defined as the time from the date of randomization to the date of death (any cause) or disease progression per RECIST 1.1, whichever occurs first as assessed by blinded independent central review (BICR)
Endpoint(s): 1.Adverse events (AE) graded according to NCI-CTCAE v5.0, clinical laboratory tests, vital signs, ECGs, and echo/MUGA, Antitumor activity will be evaluated for patients with at least one measurable lesion per Response Evaluation Criteria in Solid Tumors, Version 1.1 (RECIST 1.1) as follows: 1.Objective response rate (ORR) defined as the proportion of patients experiencing a best overall response of partial response (PR) or complete response (CR), 2.Antitumor activity will be evaluated for patients with at least one measurable lesion per Response Evaluation Criteria in Solid Tumors, Version 1.1 (RECIST 1.1) as follows: 2.Disease control rate (DCR) defined as the proportion of patients experiencing a best overall response of stable disease (SD), PR, or CR, 3.Antitumor activity will be evaluated for patients with at least one measurable lesion per Response Evaluation Criteria in Solid Tumors, Version 1.1 (RECIST 1.1) as follows: 3.Duration of response (DoR) defined as the time from the first documentation of objective response (CR or PR) to progression or to death due to any cause, whichever occurs first, 4.Antitumor activity will be evaluated for patients with at least one measurable lesion per Response Evaluation Criteria in Solid Tumors, Version 1.1 (RECIST 1.1) as follows: 4.Intracranial ORR (iORR), iDCR, iDoR, PART B 1. Efficacy will be evaluated per RECIST 1.1 as follows: a.PFS based on investigator assessment b.ORR, DoR, and DCR, by BICR and investigator assessment c.iORR, iDCR, and iDoR with measurable CNS disease by BICR and investigator assessment, 2.Overall survival (OS) defined as the time from the date of randomization to date of death, 3.Adverse events (AE) graded according to NCI-CTCAE v5.0, clinical laboratory tests, vital signs, ECGs, and echo/MUGA, 4.Minimum observed concentration (C min), 5.Measured by EQ5D-3L, EORTC QLQ-C30 and NSCL-CSAQ

Source: https://euclinicaltrials.eu/ctis-public/view/2023-503575-21-00